EU clinical trial 2023-509588-25-00: A Multicenter, Randomized, Double-Blind, Placebo-controlled Study to Assess the Efficacy and Safety of Treatment with Bepirovirsen in Participants living with Human Immunodeficiency Virus and Chronic Hepatitis B Virus Infection on Antiretroviral Treatment
Protocol code: 219231
Sponsor: Glaxosmithkline Research & Development Limited (Pharmaceutical company). Phase: Therapeutic exploratory (Phase II). Countries: France (ongoing, recruitment ended), Spain (ongoing, recruitment ended), Italy (ongoing, recruitment ended).
Therapeutic area(s): Diseases [C] - Virus Diseases [C02]
Gender: Female, Male. Age: 18-64 years, 65+ years. Enrolment: 51.
Status: Ongoing, recruitment ended. Start date (EU): 2025-02-11. Decision date: 2025-01-15. Results received: No. Last updated: 2026-03-23.
Decision dates by country: ES: 2025-01-15, FR: 2025-01-15, IT: 2025-01-17

Condition(s): Hepatitis B
Product: Placebo for Bepirovirsen Solution for Injection, 150 mg/mL SSD

Primary endpoint: Percentage of participants achieving HBsAg not detected and HBV Deoxyribonucleic acid (DNA) less than (<) Lower limit of quantification (LLOQ) at 36 weeks after scheduled end of study treatment in absence of rescue medication
Endpoint(s): Percentage of participants achieving HBsAg not detected and HBV DNA

Source: https://euclinicaltrials.eu/ctis-public/view/2023-509588-25-00